EU clinical trial 2024-513651-32-00: MYOCIT - Baricitinib in the treatment of new-onset juvenile dermatomyositis: a phase II trial
Protocol code: APHP211036
Sponsor: Assistance Publique Hopitaux De Paris (Hospital/Clinic/Other health care facility). Phase: Therapeutic exploratory (Phase II). Countries: France (ended).
Therapeutic area(s): Diseases [C] - Immune System Diseases [C20]
Gender: Female, Male. Age: 0-17 years, 18-64 years. Enrolment: 16.
Status: Ended. Start date (EU): 2022-11-10. End date (EU): 2025-05-13. Decision date: 2024-09-03. Results received: Yes. Last updated: 2024-09-03.

Condition(s): Juvenile Dermatomyositis
Product: BARICITINIB

Primary endpoint: PRINTO 20 level of improvement is defined as a 20% or greater improvement in three or more of the six variables of the juvenile dermatomyositis core set, with one or no variable worsening by more than 30% (muscle strength can not be the variable worsening)
Endpoint(s): The achievement of the PRINTO 20 levels of improvement at weeks 4, 8, 12, 16, The achievement of the PRINTO 50, 70 and 90 levels of improvement at weeks 4, 8, 12, 16, 24, Relative and absolute variations of TIS between inclusion and weeks 4, 8, 12, 16, 24, Clinically inactive disease at weeks 4, 8, 12, 24 according to the PRINTO criteria, Relative and absolute variations of CDSAI between inclusion and weeks 4, 8, 12, 16, 24, Relative and absolute variations of MYOACT between inclusion and weeks 4, 8, 12, 16, 24, Improvement of interstitial lung disease if present at screening: Improvement of pulmonary function tests (improvement of at least 10% of FCV, PTC, and DLCO) and/or improvement of Lung tomodensitomery scored according to a specific scale, Adverse events, Dose of corticosteroids at week 24, Non-compartmental analysis of baricitinib PK, Correlation between PK of baricitinib and disease activity ‘s scores, Measurement of serum IFN -α , IFN-γ, IL-1β, IL-4, Il-5, IL-6, IL-8, IL-10, IL-12p70, IL-22, TNF α at inclusion, weeks 4 and 24., Study of genes expression within 800 genes related to immunity at inclusion, weeks 4 and 24, Assessment of muscle biopsies according to the internationally validated score system (Dr Gitiaux)

Source: https://euclinicaltrials.eu/ctis-public/view/2024-513651-32-00